EU clinical trial 2022-502392-37-00: LAMSA2020: “A phase II randomized study to assess the efficacy on outcome of Venetoclax combined with Cytarabine versus Idarubicin combined with Cytarabine administered as post-remission therapy to elderly patients with acute myeloid leukemia in first remission”
Sponsor: French Innovative Leukemia Organization (Laboratory/Research/Testing facility). Phase: Therapeutic exploratory (Phase II). Countries: France (ended).
Therapeutic area(s): Diseases [C] - Hemic and Lymphatic Diseases [C15]
Gender: Female, Male. Age: 18-64 years, 65+ years. Enrolment: 114.
Status: Ended. Start date (EU): 2022-05-25. End date (EU): 2026-01-05. Decision date: 2024-07-23. Results received: No. Last updated: 2025-09-16.
Decision dates by country: FR: 2024-08-05

Condition(s): elderly patients (> = 60 years) with Acute Myeloid Leukemia

Source: https://euclinicaltrials.eu/ctis-public/view/2022-502392-37-00